EU clinical trial 2022-501418-69-00: A Phase 3, Randomized, Double-Blind, Placebo-controlled, Event-driven Study to Demonstrate the Efficacy and Safety of Milvexian, an Oral Factor XIa Inhibitor, After a Recent Acute Coronary Syndrome
Protocol code: 70033093ACS3003
Sponsor: Janssen - Cilag International (Pharmaceutical company). Phase: Therapeutic confirmatory (Phase III). Countries: Netherlands (ended), Latvia (ended), Denmark (ended), Portugal (ended), Czechia (ended), Germany (ended), Estonia (ended), Spain (ended), France (ended), Hungary (ended), Lithuania (ended), Bulgaria (ended), Austria (ended), Italy (ended), Romania (ended), Poland (ended), Greece (ended), Belgium (ended), Croatia (ended), Slovakia (ended).
Therapeutic area(s): Diseases [C] - Cardiovascular Diseases [C14]
Gender: Female, Male. Age: 18-64 years, 65+ years. Enrolment: 8535.
Status: Ended. Start date (EU): 2023-11-21. End date (EU): 2026-01-29. End date: 2026-02-06. Decision date: 2023-08-01. Results received: No. Last updated: 2026-03-11.
Decision dates by country: EE: 2023-08-07, HU: 2023-08-04, BE: 2023-08-02, GR: 2023-08-02, CZ: 2023-08-03, SK: 2023-08-04, RO: 2023-08-07, PT: 2023-08-01, NL: 2023-08-01, LT: 2023-08-06, DK: 2023-08-01, PL: 2023-08-07, AT: 2023-08-03, LV: 2023-08-07, BG: 2023-08-07, IT: 2023-08-04, FR: 2023-08-05, HR: 2023-08-04, ES: 2023-08-03, DE: 2023-08-07

Condition(s): Acute Coronary Syndrome
Product: Milvexian Matching Placebo, ACETYLSALICYLIC ACID, PRASUGREL, CLOPIDOGREL, CLOPIDOGREL, JNJ-70033093, TICAGRELOR, PRASUGREL

Primary endpoint: Time to the first occurrence of MACE
Endpoint(s): Time to the first occurrence of MAVE, Time to the first occurrence of ACM, MI, and ischemic stroke, Time to CV death, Time to ACM

Source: https://euclinicaltrials.eu/ctis-public/view/2022-501418-69-00